EU clinical trial 2025-523612-37-00: A Phase 1b, Prospective, Randomized, Double-blind, Placebo-controlled Trial Evaluating the Safety and Tolerability of Multiple Oral Doses of IRL757 in Participants with Parkinson’s Disease and Apathy
Protocol code: IRL757C003
Sponsor: Integrative Research Laboratories Sweden AB (Pharmaceutical company). Phase: Human Pharmacology (Phase I)- Other. Countries: Bulgaria (ongoing, recruiting), Poland (ongoing, recruiting), Spain (ongoing, recruiting), Germany (ongoing, recruiting).
Therapeutic area(s): Diseases [C] - Nervous System Diseases [C10]
Gender: Female, Male. Age: 18-64 years, 65+ years. Enrolment: 125.
Status: Ongoing, recruiting. Start date (EU): 2026-01-23. Decision date: 2025-12-12. Results received: No. Last updated: 2026-07-16.
Decision dates by country: DE: 2026-02-12, PL: 2025-12-22, ES: 2025-12-22, BG: 2025-12-12

Condition(s): Parkinson's Disease and Apathy
Product: Placebo capsules, IRL757, IRL757

Primary endpoint: Frequency, seriousness, and severity of AEs; change from baseline in physical examinations, clinical laboratory tests, vital signs, ECGs, C-SSRS, the QUIP-RS, and daytime sleepiness (ESS)
Endpoint(s): Change from baseline in: • NPI-C (apathy domain) • LARS

Source: https://euclinicaltrials.eu/ctis-public/view/2025-523612-37-00